EU clinical trial 2024-512354-21-00: Phase II study of iberdomide (CC220) maintenance after autologous stem cell transplantation in newly diagnosed multiple myeloma patients
Protocol code: EMN26
Sponsor: European Myeloma Network B.V., Emn Trial Office S.r.l. Impresa Sociale (Patient organisation/association, Laboratory/Research/Testing facility). Phase: Therapeutic exploratory (Phase II). Countries: France (ongoing, recruitment ended), Netherlands (ongoing, recruitment ended), Italy (ongoing, recruitment ended), Greece (ongoing, recruitment ended).
Therapeutic area(s): Diseases [C] - Neoplasms [C04]
Gender: Female, Male. Age: 18-64 years, 65+ years. Enrolment: 120.
Status: Ongoing, recruitment ended. Start date (EU): 2021-02-22. Decision date: 2024-10-10. Results received: No. Last updated: 2026-04-07.
Decision dates by country: IT: 2024-10-22, GR: 2024-12-10, NL: 2024-10-14, FR: 2024-10-10

Condition(s): Newly diagnosed multiple myeloma
Product: Iberdomide, Iberdomide, Iberdomide, Iberdomide

Primary endpoint: Response improvement rate within 6 months will be measured as the number of participants that improve response according to IMWG criteria (from PR to ≥VGPR; from VGPR to ≥CR; from CR to >sCR) within the end of sixth cycle of treatment.
Endpoint(s): TTP will be measured by protocol from the date of start of therapy and according to ITT from the date of eligibility confirmation to the date of first observation of PD, or deaths for PD. Participants who have not progressed or who withdraw from the trial or die from causes other than PD will be censored at the time of the last disease assessment. Participants lost to FU will also be censored at the time of last complete disease assessment., PFS will be measured by protocol from the date of start of therapy and according to ITT from the date of eligibility confirmation to the date of first observation of PD, or death from any cause as an event. Participants who have not progressed or who withdraw from the trial or who were lost to FU will be censored at the time of the last disease assessment., TNT will be measured by protocol from the date of start of therapy and according to ITT from the date of eligibility confirmation to the date of next anti-myeloma therapy. Death due to any cause before starting therapy will be considered an event. Participants who have not progressed or who withdraw from the trial will be censored at the time of the last disease assessment. Participants lost to FU will also be censored at the time of last contact., PFS2 will be measured by protocol from the date of start of therapy and according to ITT from the date of eligibility confirmationto the date of observation of second disease progression (i.e. progression after the second line of therapy) or death to any cause as an event. In case of date of second progression is not available, date of start of third line treatment can be used., OS is defined by protocol from the date of start of therapy and according to ITT from the date of eligibility confirmation to the date of death, regardless cause of death. Participants who withdraw consent will be censored at the time of withdrawal. Participants who are still alive at the cut-off date of final analysis will be censored at the date of last contact. Participants lost to FU will also be censored at the time of last contact., Response rate (sCR, CR, VGPR) will be evaluated according to IMWG Response criteria, Rate of NGF Minimal residual disease (MRD) conversion from positive to negative, The MRD conversion rate at 6 months is determined as the proportion of participants with MRD negativity (≥10-5 sensitivity level, by NGF) after 6 months converted from status as Positive at screening., The MRD conversion rate at 12 months is determined as the proportion of participants with MRD negativity (≥10-5 sensitivity level, by NGF) after 12 months converted from status as Positive at screening. Participants who withdraw from the trial or are lost to follow up before post 12 months MRD evaluation, the best MRD assessment will be considered., The best MRD conversion rate within 12 months is determined as the proportion of participants with MRD negativity (≥10-5 sensitivity level, by NGF) within 12 months converted from status as Positive at screening. The best MRD assessment will be considered. Participants who withdraw from the trial or are lost to follow up before MRD evaluation, the best MRD assessment will be considered., The analysis of safety as defined by type, frequency and severity will be done primarily by tabulation of the incidence of AEs as defined by the National Cancer Institute (NCI) Common Terminology Criteria for Adverse Events (CTCAE), version 5.0. In the by-participant analysis, a participant having the same event more than once will be counted only once. AEs will be summarized by worst CTCAE grade, Dose reduction will be done primarily by tabulation of the incidence of participant with at least one dose reduction and causes., Relative dose will be evaluated consider the ratio between the administered and the planned dose., Time to discontinuation for toxicity will be measured from the date of first dose of study drugs to the date of discontinuation due to AE or Death for AE/SPM. Participants who discontinued drugs due to PD, or death for cause other than AE/SPM will be considered a competing event. Participants has not discontinued and are still alive and on treatment at the cut-off date of final analysis will be censored at the cut-off date., Quality of life defined by EORTC QLQ-C30., Determine whether tumor response and outcome (PFS, PFS2, TTP, TNT and OS) may change in subgroups with different prognosis according to current prognostic factors.

Source: https://euclinicaltrials.eu/ctis-public/view/2024-512354-21-00